EU clinical trial 2024-511706-23-00: A multicenter, randomized, double-blind, parallel group, placebo-controlled study to assess the efficacy, safety, tolerability, pharmacokinetics and pharmacodynamics profile of BI 764198 administered orally once daily for 12 weeks in patients with focal segmental glomerulosclerosis.
Protocol code: 1434-0004
Sponsor: Boehringer Ingelheim International GmbH (Pharmaceutical company). Phase: Therapeutic exploratory (Phase II). Countries: Belgium (ended), Spain (ended), Germany (ended), Italy (ended), France (ended).
Therapeutic area(s): Diseases [C] - Male Urogenital Diseases [C12]; Diseases [C] - Female Urogenital Diseases and Pregnancy Complications [C13]
Gender: Female, Male. Age: 18-64 years, 65+ years. Enrolment: 31.
Status: Ended. Start date (EU): 2022-05-31. End date (EU): 2024-06-24. End date: 2025-01-03. Decision date: 2024-05-21. Results received: Yes. Last updated: 2024-10-16.
Decision dates by country: ES: 2024-05-21, DE: 2024-05-24, IT: 2024-06-03, BE: 2024-05-27, FR: 2024-06-24

Condition(s): Focal segmental glomerulosclerosis
Product: BI 764198, Placebo to match BI 764198, BI 764198, BI 764198

Primary endpoint: Number of patients achieving at least 25% reduction in 24-hour urine protein-creatinine ratio (UPCR) relative to baseline at week 12
Endpoint(s): Change in 24-hour UPCR relative to visit 3 at week 12, Change in 24-hour UPCR relative to baseline at week 13, Change in 24-hour urinary protein excretion relative to baseline at week 12, Pre-dose plasma concentration at steady state (Cpre,ss) of BI 764198 at week 4, Pre-dose plasma concentration at steady state (Cpre,ss) of BI 764198 at week 12

Source: https://euclinicaltrials.eu/ctis-public/view/2024-511706-23-00